EU clinical trial 2023-509846-36-00: Phase 1/2a Clinical Trial of BI-1206, a Monoclonal Antibody to CD32b (FcγRIIB), in Combination with Pembrolizumab in Subjects with Advanced Solid Tumors
Protocol code: 18-BI-1206-03
Sponsor: BioInvent International AB (Pharmaceutical company). Phase: Phase I and Phase II (Integrated)- Other. Countries: Sweden (ongoing, recruiting), Poland (authorised, recruiting), Romania (ongoing, recruiting), Germany (ongoing, recruiting), Spain (ongoing, recruiting).
Therapeutic area(s): Diseases [C] - Neoplasms [C04]
Gender: Female, Male. Age: 18-64 years, 65+ years. Enrolment: 129.
Start date (EU): 2020-05-29. Decision date: 2024-03-01. Results received: No. Last updated: 2026-06-23.
Decision dates by country: DE: 2026-01-29, ES: 2025-12-18, PL: 2024-11-13, RO: 2024-10-14, SE: 2024-03-01

Condition(s): Advanced Solid Tumors
Product: BI-1206, KEYTRUDA 25 mg/mL concentrate for solution for infusion, BI-1206, BI-1206

Primary endpoint: Documentation of AEs and SAEs (graded according to the NIH National Cancer Institute, Division of Cancer Treatment and Diagnosis: Common Terminology Criteria for Adverse Events (CTCAE) version 5.0 or higher, clinically significant laboratory parameters and physical findings, as well as their causality to BI-1206 and/or pembrolizumab administration., In Phase 1, identify DLT occurrence: Determination of signal-seeking dose and the MTD or maximum administered dose of BI-1206, based on the modified mTPI-2 design., In Phase 2a: Determination of the RP2D
Endpoint(s): Determination of standard PK parameters (i.e., AUC, Cmax, Tmax, and terminal half-life [t½]) for BI-1206., Measurement of ADA response to BI-1206., Blood exploratory samples. Measurement of CD32b receptor occupancy on B cells.

Source: https://euclinicaltrials.eu/ctis-public/view/2023-509846-36-00